EU clinical trial 2024-519822-18-00: An Open-Label, Long-Term Extension Study to Investigate the Safety, Tolerability, and Durability of Treatment Effect of ALKS 2680 in Subjects With Narcolepsy Type 1 and Type 2 and Idiopathic Hypersomnia
Protocol code: ALKS 2680-301
Sponsor: Alkermes Inc. (Pharmaceutical company). Phase: Phase II and Phase III (Integrated). Countries: Belgium (ongoing, recruiting), Netherlands (ongoing, recruiting), Czechia (ongoing, recruiting), Italy (ongoing, recruiting), France (ongoing, recruiting), Spain (ongoing, recruiting).
Therapeutic area(s): Diseases [C] - Nervous System Diseases [C10]
Gender: Female, Male. Age: 18-64 years, 65+ years. Enrolment: 141.
Status: Ongoing, recruiting. Start date (EU): 2025-05-14. Decision date: 2025-04-30. Results received: No. Last updated: 2026-02-06.
Decision dates by country: IT: 2025-05-07, CZ: 2025-04-30, ES: 2025-05-07, BE: 2025-04-30, FR: 2025-05-06, NL: 2025-04-30

Condition(s): Narcolepsy Type 1, Type 2 and Idiopathic Hypersomnia
Product: ALKS 2680, ALKS 2680, ALKS 2680, ALKS 2680, ALKS 2680, ALKS 2680

Primary endpoint: Treatment-emergent adverse events (TEAEs)
Endpoint(s): Clinical laboratory assessments, Vital signs, Safety electrocardiogram (ECG), Columbia-Suicide Severity Rating Scale (C-SSRS), Change in the MSL on MWT from baseline to Week 24 (for NT1 and NT2 subjects only), Change in Epworth Sleepiness Scale (ESS) from baseline through the Treatment Period, Change in the weekly cataplexy rate (WCR) from baseline through the Treatment Period (for NT1 subjects only), Change in IHSS from baseline through the Treatment Period (for IH subjects only)

Source: https://euclinicaltrials.eu/ctis-public/view/2024-519822-18-00